EU clinical trial 2023-503258-11-00: An Open-label, Single-dose Study to Evaluate the Effect of Renal Impairment on the Pharmacokinetics of Aticaprant (JNJ-67953964)
Sponsor: Janssen - Cilag International (Pharmaceutical company). Phase: Human Pharmacology (Phase I)- Other. Countries: Germany (ended).
Therapeutic area(s): Psychiatry and Psychology [F] - Mental Disorders [F03]
Gender: Female, Male. Age: 18-64 years, 65+ years. Enrolment: 48.
Status: Ended. Start date (EU): 2023-12-06. End date (EU): 2024-12-03. Decision date: 2023-11-10. Results received: No. Last updated: 2024-09-26.

Condition(s): Healthy Adult Participants

Source: https://euclinicaltrials.eu/ctis-public/view/2023-503258-11-00